EU clinical trial 2024-513845-36-00: Evaluation of vamorolone CYP3A4 induction on midazolam (a sensitive CYP3A4 substrate) pharmacokinetics
Protocol code: SNT-I-VAM-025
Sponsor: Santhera Pharmaceuticals (Schweiz) AG (Pharmaceutical company). Phase: Human Pharmacology (Phase I)- Other. Countries: Germany (ended).
Therapeutic area(s): Diseases [C] - Musculoskeletal Diseases [C05]
Gender: Female, Male. Age: 18-64 years. Enrolment: 18.
Status: Ended. Start date (EU): 2024-08-13. End date (EU): 2024-10-16. Decision date: 2024-08-05. Results received: No. Last updated: 2024-08-05.

Condition(s): Phase I study in healthy male volunteers. Intended indication: Duchenne muscular dystrophy and Becker muscular dystrophy

Source: https://euclinicaltrials.eu/ctis-public/view/2024-513845-36-00